EU clinical trial 2023-508002-20-00: A Phase 1/2 Study of DZR123 (CPI-0209) in Patients with Advanced Solid Tumors and Lymphomas
Protocol code: CDZR123A02101
Sponsor: Novartis Pharma AG (Pharmaceutical company). Phase: Phase I and Phase II (Integrated)- First administration to humans. Countries: Spain (ongoing, recruiting), Poland (ongoing, recruiting), Italy (ongoing, recruiting), France (ongoing, recruiting).
Therapeutic area(s): Diseases [C] - Neoplasms [C04]
Gender: Female, Male. Age: 18-64 years, 65+ years. Enrolment: 104.
Status: Ongoing, recruiting. Start date (EU): 2021-10-21. Decision date: 2024-04-15. Results received: No. Last updated: 2025-12-19.
Decision dates by country: IT: 2024-04-18, PL: 2024-04-16, FR: 2024-04-19, ES: 2024-04-15

Condition(s): advanced, solid, relapsed tumors / advanced tumors: human lymphomas / solid human tumor indications (urothelial carcinoma, or other advanced/metastatic solid tumors, ovarian clear cell cancer, endometrial carcinoma, lymphoma including peripheral T-cell Lymphoma and GCBDLBCL, malignant pleural or peritoneal mesothelioma, metastatic castration - resistant prostate cancer (mCRPC))
Product: DZR123, DZR123, ENZALUTAMIDE

Primary endpoint: DZR123 Monotherapy Phase 1 and Cohort M8 Part 1 Occurrence of Dose-limiting toxicities during the 1st treatment cycle DZR123 Monotherapy Phase 2 ORR: proportion of pts with a BOR of CR or PR as per RECIST 1.1 (pts with solid tumors or peritoneal mesothelioma), 2014 Lugano criteria (pts with lymphoma), Modified RECIST 1.1 criteria (pts with pleural mesothelioma), PCWG3 criteria and per Investigator assessment (pts with prostate cancer including Cohort M8 Part 2)
Endpoint(s): DZR123 Monotherapy Phase 1: Adverse events (AEs) and change in laboratory values. DZR123 Monotherapy Phase 2: PFS: the time from first dose to confirmed disease progression or death. Cohort M8 Part 1 and Cohort M8 Part 2: Incidence of AEs characterized by type, severity (graded by NCI CTCAE effective version), timing, seriousness and relationship to DZR123 and enzalutamide combination treatment., DZR123 Monotherapy Phase 1 PK and PD parameters DZR123 Monotherapy Phase 2 Time-to-progression Cohort M8 Part 1 Pharmacokinetics: plasma concentration-time profiles and standard pharmacokinetic parameters including but not limited to Cmax, Tmax, AUC0-last, AUC0-inf, t1/2, Cmin. Cohort M8 Part 2 Pharmacokinetics: plasma concentration-time profiles and standard pharmacokinetic parameters including but not limited to Cmax, Tmax, AUC0-last, AUC0-inf, t1/2, Cmin., DZR123 Monotherapy Phase 1 ORR:proportion of patients with a BOR of CR or PR, per Investigator assessment based on RECIST 1.1 or applicable response criteria DZR123 Monotherapy Phase 2 DOR:the time from the date of first response to the date of confirmed disease progression Cohort M8 Part 1 Change of pharmacodynamic biomarkers from baseline Cohort M8 Part 2 Change of pharmacodynamic biomarkers from baseline, DZR123 Monotherapy Phase 1 ORR per Gynecologic Cancer Intergroup (GCIG)-defined CA-125 response criteria (ovarian cancer patients) DZR123 Monotherapy Phase 2 TTR, defined as the time from first dose to date of first response Cohort M8 Part 1 Objective response, per Investigator assessment based on PCWG3 Cohort M8 Part 2 DOR, defined as the time from the date of first response to the date of confirmed disease progression., DZR123 Monotherapy Phase 1: ORR per PCWG3 (in Phase 1 prostate cancer patients only) DZR123 Monotherapy Phase 2 Disease control rate: the proportion of patients with a BOR of CR, PR, or SD per cohort and DZR123 dose level Cohort M8 Part 1 DOR: the time from the date of first response to the date of disease progression per PCWG3 Cohort M8 Part 2 Progression-free survival (PFS) as per PCWG3 and defined as the time from first dose to confirmed disease progression or death, DZR123 Monotherapy Phase 1 Progression-free survival (PFS), defined as the time from first dose to confirmed disease progression or death DZR123 Monotherapy Phase 2 ORR per GCIG-defined CA-125 response criteria (ovarian cancer patients) Cohort M8 Part 1 Disease control defined as best overall response of CR, PR, or stable disease (SD) per PCWG3. Cohort M8 Part 2 Proportion of patients with PSA response ≥50%., DZR123 Monotherapy Phase 1 DOR, defined as the time from the date of first response to the date of confirmed disease progression DZR123 Monotherapy Phase 2 Overall survival (OS), defined as the time from first dose to death Cohort M8 Part 1 PSA50 response, defined as PSA decline by >=50% from baseline. Cohort M8 Part 2 Time to PSA progression., DZR123 Monotherapy Phase 1 Time to response (TTR), defined as the time from first dose to date of first response DZR123 Monotherapy Phase 2 AEs and changes in laboratory values Cohort M8 Part 1 Probability of DLT over dose range Cohort M8 Part 2 Overall survival (OS), defined as the time from first dose to death in patients with mCRPC, DZR123 Monotherapy Phase 1 Disease control rate, defined as the proportion of patients with a best overall response of CR, PR, or stable disease (SD) DZR123 Monotherapy Phase 2 9. PK and PD parameters In Cohort M7 only: PK parameters of DZR123 monotherapy at 300 mg dose with and without a HFHC meal in patients with ARID1A WT endometrial carcinoma

Source: https://euclinicaltrials.eu/ctis-public/view/2023-508002-20-00